EU clinical trial 2022-501252-28-00: A Phase 2, Multicenter, Randomized Study to Compare the Efficacy and Safety of MK-7684A or MK-7684A Plus Docetaxel Versus Docetaxel Monotherapy in the Treatment of Participants With Metastatic Non-small Cell Lung Cancer With Progressive Disease After Treatment With a Platinum Doublet Chemotherapy and Immunotherapy
Protocol code: MK-7684A-002
Sponsor: Merck Sharp & Dohme LLC (Pharmaceutical company). Phase: Therapeutic exploratory (Phase II). Countries: Spain (ended), Denmark (ended), Italy (ended), Finland (ended), Germany (ended), Belgium (ended), France (ended), Austria (ended), Poland (ended).
Therapeutic area(s): Diseases [C] - Neoplasms [C04]
Gender: Female, Male. Age: 18-64 years, 65+ years. Enrolment: 150.
Status: Ended. Start date (EU): 2021-04-15. End date (EU): 2024-10-10. End date: 2024-10-17. Decision date: 2023-02-13. Results received: Yes. Last updated: 2024-11-25.
Decision dates by country: DE: 2023-03-06, PL: 2023-03-28, FI: 2023-02-16, DK: 2023-02-15, BE: 2023-03-20, FR: 2023-02-16, IT: 2023-03-17, AT: 2023-03-28, ES: 2023-02-13

Condition(s): Non Small Cell Lung cancer
Product: MK-7684A, Placebo to MK-7684A - normal saline, DOCETAXEL

Primary endpoint: Progression Free Survival (PFS) per Response Evaluation Criteria in Solid Tumors version 1.1 (RECIST 1.1) by Blinded Independent Central Review (BICR) Assessment
Endpoint(s): Objective Response (OR) per RECIST 1.1 by BICR Assessment, Overall Survival (OS), Duration of Response (DOR) per RECIST 1.1 by BICR Assessment, Number of Participants Who Experienced an Adverse Event (AE), Number of Participants Who Discontinued Study Treatment Due to an AE

Source: https://euclinicaltrials.eu/ctis-public/view/2022-501252-28-00